EU clinical trial 2024-518436-37-01: Repurposing Metformin as a Leukemia-preventive Drug in CCUS and LR-MDS
Sponsor: Rigshospitalet (Hospital/Clinic/Other health care facility). Phase: Therapeutic exploratory (Phase II). Countries: Denmark (ongoing, recruiting).
Therapeutic area(s): Diseases [C] - Neoplasms [C04]; Diseases [C] - Hemic and Lymphatic Diseases [C15]
Gender: Female, Male. Age: 18-64 years, 65+ years. Enrolment: 70.
Status: Ongoing, recruiting. Start date (EU): 2021-12-01. Decision date: 2025-01-27. Results received: No. Last updated: 2025-12-19.

Condition(s): Myelodysplastic syndromes (MDS), very low- and low-risk, Clonal cytopenia of undetermined significance (CCUS)
Product: METFORMIN HYDROCHLORIDE

Primary endpoint: WP0: To investigate: 1. The abundance and properties of bone marrow adipose tissue and bone marrow adipocytes, and 2. the gut microbiota and 3. the intestinal permeability of patients with CCUS or LR-MDS compared to age-, sex- and body mass index (BMI)-matched healthy controls., WP1: Feasibility: 1. Recruitment and refusal rates and 12 months follow-up rates. 2. The number of participants who receive the intervention. 3. Protocol adherence. 4. Acceptability of interventions. Safety: 1. Numbers of adverse events and serious adverse events. 2. Numbers of suspected unexpected serious adverse reactions. 3. Drop-out rates. 4. Changes in individual medication doses including median maximum tolerated dose.
Endpoint(s): WP0: To characterize: 1. DNA methylation and hydroxymethylation (5-mC and 5-hmC) patterns, and 2. hormone and cytokine levels in bone marrow plasma from healthy controls, and 3. compare these to the corresponding in patients from visit 1 in WP1., WP1: Change in: 1. Variant allele frequency from visit 1 to 4. 2. Patient-reported outcome measures, based on the EORTC QLQ-C30, SF-36, and EQ-5D from visit 1 to 2, 3, and 4. 3. Bone marrow adipose tissue (BMAT) from visit 1 to 2 and 4. 4. Bone mineral density from visit 1 to 4. 5. Body composition from visit 1 to 4. 6. Fat distribution from visit 1 to 4. 7. Blast counts in bone marrow biopsies from visit 1 to 4. 8. Gut microbiota from visit 1 to 2 and 4., WP1 continued: Change in: 9. Small intestinal permeability from visit 1 to 2. 10. 5-mC and 5-hmC patterns, RNA expression, and protein profiles in hematopoietic cells, adipocytes, and MSCs from visit 1 to 2 and 4. 11. Disease status as according to the IWG response criteria from visit 1 to 4. 12. Inflammatory markers, hormones, and niche factors in blood and bone marrow plasma from visit 1 to 2 and 4. 13. Markers of organ function and serum biochemistry from visit 1 to 2, 3, and 4.

Source: https://euclinicaltrials.eu/ctis-public/view/2024-518436-37-01